EU clinical trial 2023-504445-31-00: C5731005 _ A Phase 2 Basket Study of Disitamab Vedotin in Adult Subjects with Previously Treated, Locally-Advanced Unresectable or Metastatic Solid Tumors That Express HER2
Protocol code: C5731005 / SGNDV-005
Sponsor: Seagen Inc. (Pharmaceutical company). Phase: Therapeutic exploratory (Phase II). Countries: Italy (ongoing, recruitment ended), France (not authorised), Germany (ended), Spain (ongoing, recruitment ended).
Therapeutic area(s): Diseases [C] - Neoplasms [C04]
Gender: Female, Male. Age: 18-64 years, 65+ years. Enrolment: 28.
Start date (EU): 2024-09-19. Decision date: 2024-05-28. Results received: No. Last updated: 2026-02-26.
Decision dates by country: FR: 2024-06-03, DE: 2024-05-29, ES: 2024-05-28, IT: 2024-05-29

Condition(s): Carcinoma, Head and Neck, Ovarian Neoplasms, Carcinoma, Non-Small-Cell Lung, Endometrial Neoplasms
Product: Disitamab Vedotin

Primary endpoint: Confirmed objective response rate (ORR) per Response Evaluation Criteria in Solid Tumors version 1.1 (RECIST v1.1) as assessed by the investigator.
Endpoint(s): Type, incidence, severity, seriousness, and relatedness of adverse events (AEs) including AEs of special interest (AESIs)., Type, incidence, and severity of laboratory abnormalities as well as significant changes from baseline, Frequency of treatment interruptions, dose reductions and treatment discontinuations due to AEs., Confirmed disease control rate (DCR) per RECIST v1.1 as assessed by the investigator, Duration of response (DOR) per RECIST v1.1 as assessed by the investigator, Progression free survival (PFS) per RECIST v1.1 as assessed by the investigator, Overall survival (OS), Select PK parameters of disitamab vedotin, total antibody (TAb) and unconjugated MMAE, Incidence of antidrug antibodies (ADA) against disitamab vedotin

Source: https://euclinicaltrials.eu/ctis-public/view/2023-504445-31-00